EU clinical trial 2023-505570-15-00: Phase 2 study evaluating the efficacy of injectable gentamicin in hereditary ichthyosis - GENTIC
Protocol code: RC31/22-0320
Sponsor: Centre Hospitalier Universitaire De Toulouse (Hospital/Clinic/Other health care facility). Phase: Therapeutic exploratory (Phase II). Countries: France (ongoing, recruiting).
Therapeutic area(s): Diseases [C] - Skin and Connective Tissue Diseases [C17]
Gender: Female, Male. Age: 18-64 years, 65+ years. Enrolment: 26.
Status: Ongoing, recruiting. Start date (EU): 2025-01-29. Decision date: 2024-02-06. Results received: No. Last updated: 2026-03-30.

Condition(s): Congenital Ichthyosis
Product: Gentamicin Panpharma 40 mg/ml solution for injection/infusion

Primary endpoint: Proportion of patients with a decrease in VIIS (Visual Index of Ichthyosis Severity) score (which calculates severity based on assessment of scales and erythema in 4 different areas) of at least 15% at M3 versus baseline (mean M-3, M-2, M-1, M0)
Endpoint(s): Evaluation of the severity of scaling and erythema by the VIIS score, at M1, M2, M4, M5, M6 and M9 versus baseline, Evaluation of pruritus by VAS 0-10 at M1, M2, M3, M4, M5, M6 and M9, versus baseline, Evaluation of TEWL (transepidermal water loss) measured on the anterior aspect of the forearm (area classically chosen for measurement) using a tewameter at M1, M2, M3 and M6, versus baseline, Collection of adverse events throughout the study: creatinine and creatinine clearance (before each injection), bacteriology with antibiogram (baseline, M3 and M6), vestibular function test (baseline, M1, M2, M3 and M6) for nystagmus by videonystagmoscopy (VNS), audiogram (baseline, M1, M2, M3 and M6) and video Head Impulse Test (baseline, M1, M2, M3 and M6) and videonystagmography (baseline and M6), Evaluation of the physician's IGA (Investigator Global Assessment) and the patient's PtGA (Patient Global Assessment) (at M1, M2, M3, M4, M5, M6 and M9, versus baseline, Evaluation of protein expression on skin biopsy from the inner arm, by western blot (quantitative analysis), at M3 versus baseline, Evaluation of quality of life by the IQoL-32 score (specific to ichthyosis) at M3, M6 and M9, versus baseline,, Global satisfaction questionnaire completed by the patient at M6

Source: https://euclinicaltrials.eu/ctis-public/view/2023-505570-15-00